EU clinical trial 2024-517098-26-00: Multicentric trial evaluating the correlation between early PSMA-PET change and response to systemic treatment for first-line metastatic clear cell Renal Carcinoma Cell.
Protocol code: PSMA-RENAL
Sponsor: Cliniques Universitaires Saint-Luc (Hospital/Clinic/Other health care facility). Phase: Therapeutic exploratory (Phase II). Countries: Belgium (authorised, recruitment pending).
Therapeutic area(s): Diseases [C] - Pathological Conditions, Signs and Symptoms [C23]
Gender: Female, Male. Age: 18-64 years, 65+ years. Enrolment: 75.
Status: Authorised, recruitment pending. Decision date: 2025-03-21. Results received: No. Last updated: 2026-02-13.

Condition(s): metastatic clear cell Renal Carcinoma Cell
Product: GOZETOTIDE

Primary endpoint: Correlation between the change in expression of PSMA expression between baseline and 6-week timepoint and the 6-month Disease Control Rate on anticancer treatment (ICI + TKI or ICI + ICI). The DCR is defined as the number of patients with o Complete response (CR), o Partial response (PR) o Stable disease (SD)) o Patients deceased or lost-of follow-up will be considered as progressive disease (PD). o Patients with a non evaluable assessment will also be categorized as non-responders.
Endpoint(s): o Correlation between the change in expression of PSMA on PSMA-PET/CT performed 6-weeks after anticancer treatment initiation and Objective Response Rate (ORR, defined as number of patients with CR and PR), o Correlation between baseline 68Ga-PSMA-PET expression and DCR, o Correlation between the change in expression of PSMA on PSMA PET/CT performed 6-weeks after anticancer treatment initiation and Progression-free survival (PFS) calculated as the time from the treatment start to disease progression, death, or last follow-up.

Source: https://euclinicaltrials.eu/ctis-public/view/2024-517098-26-00